EU clinical trial 2024-514890-24-00: Phase I/II, Multicenter, Open-label, Clinical and Pharmacokinetic Study of PM14 in Combination with Irinotecan in Pretreated Patients with Selected Advanced Solid Tumors
Protocol code: PM14-A-002-20
Sponsor: Pharma Mar S.A. (Pharmaceutical company). Phase: Therapeutic exploratory (Phase II). Countries: Spain (ended).
Therapeutic area(s): Diseases [C] - Neoplasms [C04]
Gender: Female, Male. Age: 18-64 years, 65+ years. Enrolment: 45.
Status: Ended. Start date (EU): 2021-07-23. End date (EU): 2025-07-16. Decision date: 2024-08-12. Results received: Yes. Last updated: 2025-02-03.

Condition(s): Patients with Selected Advanced Solid Tumors
Product: PM14, IRINOTECAN

Primary endpoint: Dose escalation stage: Determination of MTD and RD: the MTD will be the lowest dose level explored during dose escalation at which one third or more of evaluable patients develop a DLT in Cycle 1. This protocol follows European terminology; thus, the RD and the MTD are not equivalent. Expansion cohorts will be performed starting at this resultant RD, not at the MTD, Expansion stage: Overall response rate, defined as the percentage of evaluable patients with a confirmed response, either complete (CR) or partial (PR), from the start of treatment to the date of progression or the start of a subsequent therapy or end of patient’s follow-up, according to the RECIST v.1.1, as appropriate.
Endpoint(s): Safety: patients will be evaluable for safety if they have received at least one partial infusion of irinotecan and/or PM14. AEs will be graded according to the National Cancer Institute Common Terminology Criteria for Adverse Events (NCI-CTCAE) v.5. Additionally, treatment-related discontinuations and treatment compliance (dose reduction, skipped doses and/or treatment delays due to AEs), will be described, Pharmacokinetics: PK analyses will be evaluated in plasma by standard non-compartmental analysis (population pharmacokinetic modeling may be performed if appropriate). Plasma samples for PK analysis will be obtained in Cycle 1 from all patients., Pharmacogenetics: the presence or absence of PGt polymorphisms in genes relevant for PM14 disposition (distribution, metabolism and excretion) from a single blood sample collected at any time during the trial (but preferably at the same time as the pre-treatment PK sample on Day 1 of Cycle 1) will be assessed to explain individual variability in main PM14 PK parameters, Pharmacogenomics: the mutational status and the expression levels of potential predictive factors of response and/or resistance to PM14 and irinotecan treatment will be analyzed from available tumor and/or blood samples obtained at diagnosis and/or during treatment (at response and/or relapse). Their correlation with the clinical response and outcome after treatment will be assessed., Efficacy: patients will be evaluable for efficacy if they receive at least one complete infusion of both PM14 and irinotecan and have at least one clinical or radiological tumor assessment as per RECIST v.1.1, or if they are considered to have failed treatment. Treatment failure will be defined as symptomatic/clinical deterioration (disease related) or clinical progression, death due to malignant disease or treatment discontinuation due to any treatment-related AE before any appropriate tumor

Source: https://euclinicaltrials.eu/ctis-public/view/2024-514890-24-00